EU clinical trial 2024-519387-41-00: FusionVAC22_02: DNAJB1-PRKACA fusion transcript-based peptide vaccine for fibrolamellar hepatocellular carcinoma patients and other tumor entities carrying the oncogenic driver fusion
Protocol code: FusionVAC22_02
Sponsor: Universitaetsklinikum Tuebingen AöR (Hospital/Clinic/Other health care facility). Phase: Human Pharmacology (Phase I)- First administration to humans. Countries: Germany (ongoing, recruiting).
Therapeutic area(s): Not possible to specify
Gender: Female, Male. Age: 0-17 years, 18-64 years. Enrolment: 20.
Status: Ongoing, recruiting. Start date (EU): 2025-05-07. Decision date: 2025-03-20. Results received: No. Last updated: 2025-06-17.

Condition(s): tumor entities carrying the oncogenic driver fusion, fibrolamellar heptocelluar carcinoma
Product: Fusion-VAC-XS15

Primary endpoint: The study analyses efficacy and safety as primary objectives. Primary objectives of the planned trial are (i) to assess immunogenicity in terms of induction of peptide specific T-cell responses and (ii) to assess safety and toxicity of the peptide vaccine. The safety and toxicity of the DNAJB1-PRKACA fusion transcript-based peptide vaccine is determined based on the Common Terminology Criteria for Adverse Events (CTCAE V 5.0) and assessed in a descriptive manner
Endpoint(s): Percentage of patients with induction of a peptide specific T-cell response at eachscheduled visit until EOS visit compared to baseline (visit V1 prior to first vaccination)as determined by IFNγ ELISPOT, Number and percentage of patients receiving a booster vaccination or to be scheduledto receive a booster vaccination out of all patients, Incidence and severity of adverse events (AEs) including AESIs, SAEs and SUSARs(CTCAE V5.0) from first vaccination at visit V1 until end of study (EOS) visit or, incase of early termination before EOT or EOT (B), last assessment., Disease control rate (CR, PR, SD) ) assessed by RECIST1.1 at each visit until end of study, PFS from the date of first vaccination until the date of progressive disease accordingto RECIST1.1 or death from any cause, OS from the date of first vaccination until the date of death from any cause, Overall quality of life scores (EORTC QLQ C-30) at every scheduled visit until EOSvisit.

Source: https://euclinicaltrials.eu/ctis-public/view/2024-519387-41-00